EU clinical trial 2025-524495-39-00: Direct comparison of Tezepelumab and Dupilumab in CRSwNP in a real world setting
Protocol code: DIRECTION
Sponsor: Medical University Of Vienna (Educational Institution). Phase: Therapeutic use (Phase IV). Countries: Austria (authorised, recruitment pending).
Therapeutic area(s): Diseases [C] - Otorhinolaryngologic Diseases [C09]
Gender: Female, Male. Age: 18-64 years, 65+ years. Enrolment: 220.
Status: Authorised, recruitment pending. Decision date: 2026-03-22. Results received: No. Last updated: 2026-03-22.

Condition(s): Chronic Rhinosinusitis with Nasal Polyps
Product: Dupixent 200 mg solution for injection in pre-filled pen, Tezspire 210 mg solution for injection in pre-filled syringe

Primary endpoint: The change in NPS score (0-8 points) or the change in SNOT-22 (Scale of 0-110) from baseline to 12 months.
Endpoint(s): Percentage of patients with good-excellent (4-5 criteria), poor-moderate (1-3 criteria) and no response (0 criteria) according to EPOS/EUROFREA criteria during one year of therapy with Dupilumab or Tezepelumab, Change in in QoL parameters (e.g., SNOT-22 score and subcategories, scale 0-110, EQ-5D-3L, scale: 5-15) and clinical parameters (e.g. NPS, scale: 0-8; ECP, 0-200µg/L) during one year of therapy with Dupilumab or Tezepelumab, Change in objective (Sniffin’sticks, 0-16 points) and subjective (VAS for olfactory performance (0-10cm), SNOT 22 items) during one year of therapy with Dupilumab or Tezepelumab, change in peak nasal inspiratory flow (PNIF, 0-370 L/min) or FEV 1 (spirometer, 0-ca.120%(young patients)) during one year of therapy with Dupilumab or Tezepelumab, change in perception of asthma control (ACT 0-25 Points or AQLQ 0-105 points) during one year of therapy with Dupilumab or Tezepelumab, change in perception of CRS symptoms (VAS, 0-10 cm) during one year of therapy with Dupilumab or Tezepelumab, occurrence of side effect as determined by diary or patients oral report during one year of therapy with Dupilumab or Tezepelumab, change in routine blood parameters, Change in allergic symptoms (TRSS 0-21 points, questionnaire) and allergic sensitization (skin prick test, number of sensitizations) during one year of treatment with Dupilumab or Tezepelumab, Change in diversity (Chao1 and Shannon Index, 0-open) and abundance (0-open) of the nasal microbiome during one year of treatment with Dupilumab or Tezepelumab, Change in relative levels of mediators (Normalized Protein Expression=NPX, 0-open) as determined by OLINK during one year of treatment with Dupilumab or Tezepelumab, Change in relative gene expression (Δ Cycle threshold (Ct): Difference between Ct of the target gene and a reference gene, 0-open) of oxidative stress response induced genes during one year of treatment with Dupilumab or Tezepelumab, Change in allergic sensitization (allergen-specific IgE levels, kUA/L) in nasal secretions and serum during one year of treatment with Dupilumab or Tezepelumab

Source: https://euclinicaltrials.eu/ctis-public/view/2025-524495-39-00